EU clinical trial 2024-512027-36-00: COMPIS - Congenital myopathy intervention study. An open-label, cross over, randomized, controlled study using salbutamol
Protocol code: COMPIS
Sponsor: Vaestra Goetalandsregionen (Hospital/Clinic/Other health care facility). Phase: Therapeutic use (Phase IV). Countries: Sweden (ended).
Therapeutic area(s): Diseases [C] - Congenital, Hereditary, and Neonatal Diseases and Abnormalities [C16]
Gender: Female, Male. Age: 0-17 years, 18-64 years. Enrolment: 20.
Status: Ended. Start date (EU): 2021-09-27. End date (EU): 2025-03-17. Decision date: 2024-04-02. Results received: No. Last updated: 2024-10-28.

Condition(s): Congenital myopathy
Product: Ventoline 0,4 mg/ml oral lösning., SALBUTAMOL WZF, 2 mg, tabletki, SALBUTAMOL WZF, 4 mg, tabletki

Primary endpoint: Increase of MFM32 test after 6 months of treatment as compared to no treatment.
Endpoint(s): Increased walking distance during 6-minute walking test after 6 months of treatment., Less fatigability during physical activity after 6 months of treatment: assessed by comparing subjects speed (m/min) during the first and last minute of 6 minute walking test., Decreased time needed to complete timed function tests (10 m walk/run, 4 steps and down) after 6 months treatment., Increased hand strength on hand held myometry after 6 months on treatment., Less fatigability in upper extremities during physical examination: assessed with 5 consecutive 9 hole peg tests, where time of completion of first set is compared with time of completion of the last set., Increase in forced vital capacity both sitting and lying down after 6 months of treatment., Improvement of quality of life after 6 months of treatment.

Source: https://euclinicaltrials.eu/ctis-public/view/2024-512027-36-00